EU clinical trial 2023-504834-23-00: A Phase 3, Randomized Study to Evaluate the Efficacy and Safety of Lenvatinib (E7080/MK-7902) plus Pembrolizumab (MK-3475) plus Chemotherapy Compared with Standard of Care Therapy as First-line Intervention in Participants with Advanced/Metastatic Gastroesophageal Adenocarcinoma (LEAP-015)
Protocol code: MK-7902-015
Sponsor: Merck Sharp & Dohme LLC (Pharmaceutical company). Phase: Phase III and phase IV (Integrated). Countries: Spain (ended), Belgium (ended), Germany (ended), France (ended), Italy (ended), Ireland (ended), Poland (ended).
Therapeutic area(s): Diseases [C] - Neoplasms [C04]
Gender: Female, Male. Age: 18-64 years, 65+ years. Enrolment: 231.
Status: Ended. Start date (EU): 2021-02-24. End date (EU): 2026-03-19. End date: 2026-03-30. Decision date: 2023-12-20. Results received: No. Last updated: 2026-04-01.
Decision dates by country: ES: 2023-12-20, DE: 2024-01-09, IT: 2024-01-08, IE: 2023-12-20, BE: 2024-01-08, PL: 2024-05-27, FR: 2023-12-20

Condition(s): Advanced/Metastatic Gastroesophageal Adenocarcinoma
Product: CAPECITABINE, CALCIUM FOLINATE, KEYTRUDA 25 mg/mL concentrate for solution for infusion, Calciumfolinat Kabi 10 mg/ml Injektions-/Infusionslösung, FLUOROURACIL, Lenvatinib, Lenvatinib, Calciumfolinat-GRY® 100 mg/10 ml Injektionslösung, OXALIPLATIN, Lenvatinib, CALCIUM LEVOFOLINATE, CAPECITABINE

Primary endpoint: Part 1: Number of Participants with Dose Limiting Toxicities (DLTs), Part 1: Number of Participants with Adverse Events (AEs), Part 1: Number of Participants who Discontinued Study Treatment Due to an AE, Part 2: Overall Survival (OS) in Participants with Programmed Cell Death Ligand 1 (PD-L1) Combined Positive Score (CPS) ≥1, Part 2: OS in All Participants, Part 2: Progression-Free Survival (PFS) Per Response Evaluation Criteria in Solid Tumors version 1.1 (RECIST 1.1) as Assessed by Blinded Independent Central Review (BICR) in Participants with PD-L1 CPS ≥1, Part 2: PFS Per RECIST 1.1 as Assessed by BICR in All Participants
Endpoint(s): Part 2: Objective Response Rate (ORR) Per RECIST 1.1 as Assessed by BICR in Participants with PD-L1 CPS ≥1, Part 2: ORR Per RECIST 1.1 as Assessed by BICR in All Participants, Part 2: Duration of Response (DOR) Per RECIST 1.1 as Assessed by BICR in Participants with PD-L1 CPS ≥1, Part 2: DOR Per RECIST 1.1 as Assessed by BICR in All Participants, Part 2: Number of Participants with AEs, Part 2: Number of Participants who Discontinued Study Treatment Due to an AE

Source: https://euclinicaltrials.eu/ctis-public/view/2023-504834-23-00